EU clinical trial 2025-523431-19-00: A Randomized, Double-Blind, Placebo-Controlled, Phase 2 Proof of Concept (POC) Study Evaluating the Safety, Tolerability, and Efficacy of Nintedanib Solution for Inhalation (AP02) in Participants with Idiopathic Pulmonary Fibrosis (IPF) (AURA-IPF)
Protocol code: AP02-003
Sponsor: Avalyn Pharma Inc. (Pharmaceutical company). Phase: Therapeutic exploratory (Phase II). Countries: Germany (authorised, recruiting), Italy (authorised, recruitment pending), Spain (ongoing, recruiting).
Therapeutic area(s): Diseases [C] - Respiratory Tract Diseases [C08]
Gender: Female, Male. Age: 18-64 years, 65+ years. Enrolment: 96.
Start date (EU): 2026-05-20. Decision date: 2026-03-26. Results received: No. Last updated: 2026-07-07.
Decision dates by country: ES: 2026-04-13, DE: 2026-04-01, IT: 2026-03-26

Condition(s): Idiopathic Pulmonary Fibrosis (IPF)
Product: AP02 Placebo, AP02 Low, AP02 High

Primary endpoint: Change from baseline in the morning pre-dose forced vital capacity (FVC) (mL) at Week 12
Endpoint(s): Time to disease progression. Disease progression is defined as FVC percent predicted decline of ≥10% prior to Week 12, respiratory hospitalization, or death., Change from baseline in quantitative lung fibrosis metrics on HRCT at Week 12

Source: https://euclinicaltrials.eu/ctis-public/view/2025-523431-19-00